EU clinical trial 2022-502866-25-00: A first in human single dose escalation study to investigate the safety, tolerability, pharmacokinetics, and pharmcodynamics of BAY 3389934 compared with placebo.
Protocol code: 22157
Sponsor: Bayer AG (Pharmaceutical company). Phase: Human Pharmacology (Phase I)- First administration to humans. Countries: Germany (ended).
Therapeutic area(s): Diseases [C] - Cardiovascular Diseases [C14]
Gender: Female, Male. Age: 18-64 years. Enrolment: 86.
Status: Ended. Start date (EU): 2023-08-18. End date (EU): 2025-01-29. Decision date: 2023-07-21. Results received: No. Last updated: 2025-01-15.

Condition(s): Sepsis associated disseminated intravascular coagulation

Source: https://euclinicaltrials.eu/ctis-public/view/2022-502866-25-00